EU clinical trial 2024-518949-14-00: Beta-blockade with landiolol in out-of-hospital cardiac arrest: a randomized, double-blind, placebo-controlled, pilot trial
Sponsor: Medical University Of Vienna (Educational Institution). Phase: Therapeutic exploratory (Phase II). Countries: Austria (ongoing, recruiting).
Therapeutic area(s): Diseases [C] - Cardiovascular Diseases [C14]
Gender: Female, Male. Age: 18-64 years, 65+ years. Enrolment: 48.
Status: Ongoing, recruiting. Start date (EU): 2020-11-30. Decision date: 2024-12-10. Results received: No. Last updated: 2024-12-10.

Condition(s): cardiac arrest, ventricular fibrillation
Product: Rapibloc 20 mg/2 ml Konzentrat zur Herstellung einer Injektionslösung, Sodium Chloride Injection/Fresenius, 0,9% w/v, διάλυμα για έγχυση

Primary endpoint: Time (in minutes) to sustained return of spontaneous circulation
Endpoint(s): cummulative ROSC, temporary ROSC, sustained ROSC, survival at 24h, favorable neurologic outcome

Source: https://euclinicaltrials.eu/ctis-public/view/2024-518949-14-00